EU clinical trial 2023-505813-26-00: A safety study of PF-08046044/SGN-35C in adults with advanced cancers
Protocol code: C5801001/SGN35C-001
Sponsor: Seagen Inc. (Pharmaceutical company). Phase: Human Pharmacology (Phase I)- First administration to humans. Countries: France (ended), Spain (ended), Denmark (ended), Germany (ended), Italy (ended).
Therapeutic area(s): Diseases [C] - Neoplasms [C04]
Gender: Female, Male. Age: 18-64 years, 65+ years. Enrolment: 48.
Status: Ended. Start date (EU): 2024-09-12. End date (EU): 2026-04-08. End date: 2026-04-09. Decision date: 2024-07-30. Results received: No. Last updated: 2026-04-21.
Decision dates by country: DE: 2024-10-02, FR: 2024-07-30, IT: 2024-07-30, DK: 2024-07-31, ES: 2024-07-30

Condition(s): Lymphoma, Large B-Cell, Diffuse, Lymphoma, Large-Cell, Anaplastic, Hodgkin Disease, Lymphoma, T-Cell, Peripheral

Source: https://euclinicaltrials.eu/ctis-public/view/2023-505813-26-00